EU clinical trial 2025-524845-28-00: HORUS-Cytomegalovirus Open Proof-of-concept Exploratory trial
Protocol code: HORUS-COPE
Sponsor: Centre Hospitalier Universitaire Vaudois (Hospital/Clinic/Other health care facility). Phase: Therapeutic use (Phase IV). Countries: France (authorised, recruitment pending).
Therapeutic area(s): Diseases [C] - Virus Diseases [C02]
Gender: Female, Male. Age: 18-64 years, 65+ years. Enrolment: 60.
Status: Authorised, recruitment pending. Decision date: 2026-08-07. Results received: No. Last updated: 2026-08-07.

Condition(s): Cytomegalovirus infection in solid-organ transplant recipients.
Product: EVEROLIMUS, MYCOPHENOLIC ACID

Primary endpoint: Change in CMV Viral Load (log10 IU/mL) from Baseline to Week 3.
Endpoint(s): Change in the CMV-specific Immune Signature., Ability of baseline immune signature to stratify patients.

Source: https://euclinicaltrials.eu/ctis-public/view/2025-524845-28-00